EU clinical trial 2024-514833-39-00: clinical trial to determine the feasibility and safety of the mesenchymal stem cells use in women over 50 years of age with urinary incontinencee
Protocol code: SUITH
Sponsor: Instituto De Investigacion Sanitaria Fundacion Jimenez Diaz (Laboratory/Research/Testing facility). Phase: Human Pharmacology (Phase I)- Other. Countries: Spain (ongoing, recruiting).
Therapeutic area(s): Diseases [C] - Female Urogenital Diseases and Pregnancy Complications [C13]
Gender: Female. Age: 65+ years. Enrolment: 60.
Status: Ongoing, recruiting. Start date (EU): 2024-12-16. Decision date: 2024-10-07. Results received: No. Last updated: 2025-09-01.

Condition(s): Stress or mixed urinary incontinence in women over 50 years of age not responding to conventional treatments

Source: https://euclinicaltrials.eu/ctis-public/view/2024-514833-39-00